EU clinical trial 2024-516786-37-00: HER2-Targeting Site-Specific Labelled 89Zr-Trastuzumab PET Imaging of Patients with Cancer
Protocol code: AK-HER2-001
Sponsor: Rigshospitalet (Hospital/Clinic/Other health care facility). Phase: Human Pharmacology (Phase I)- First administration to humans. Countries: Denmark (ongoing, recruiting).
Therapeutic area(s): Diseases [C] - Neoplasms [C04]
Gender: Female, Male. Age: 18-64 years, 65+ years. Enrolment: 140.
Status: Ongoing, recruiting. Start date (EU): 2025-09-22. Decision date: 2024-11-05. Results received: No. Last updated: 2025-06-04.

Condition(s): Patients with breast cancer, gastroesophageal adenocarcinomas or cancers with alterations in the ERBBR2 gene

Source: https://euclinicaltrials.eu/ctis-public/view/2024-516786-37-00